EU clinical trial 2025-523923-22-00: A Phase 2, Open-Label, Single-Arm Study of Lirafugratinib in Patients With Previously Treated, Unresectable, Locally Advanced or Metastatic Solid Tumors (Excluding Cholangiocarcinoma) With FGFR2 Fusion or Rearrangement
Protocol code: ELE-4008-202
Sponsor: Elevar Therapeutics Inc. (Pharmaceutical company). Phase: Therapeutic exploratory (Phase II). Countries: France (authorised, recruitment pending), Spain (authorised, recruitment pending).
Therapeutic area(s): Diseases [C] - Neoplasms [C04]
Gender: Female, Male. Age: 18-64 years, 65+ years. Enrolment: 14.
Status: Authorised, recruitment pending. Decision date: 2026-07-09. Results received: No. Last updated: 2026-07-24.
Decision dates by country: FR: 2026-07-09, ES: 2026-07-10

Condition(s): Previously Treated, Unresectable, Locally Advanced or Metastatic Solid Tumors (Excluding Cholangiocarcinoma) With FGFR2 Fusion or Rearrangement
Product: Lirafugratinib, Lirafugratinib

Primary endpoint: ORR assessed by IRC per RECIST v1.1
Endpoint(s): DOR assessed by IRC per RECIST v1.1, • Incidence, severity, and causality of TEAEs, treatment-related TEAEs, SAEs, AESIs, clinically significant change from baseline in laboratory values, ECG, vital signs, and other safety findings judged according to NCI CTCAE v5.0 from the first dose of lirafugratinib to the last Safety Follow-Up Visit • Dose intensity • Dose modifications (i.e., dose interruption, dose reduction, and dose discontinuation) • Concomitant treatment of ADRs, • ORR and DOR assessed by Investigator per RECIST v1.1 • DCR and PFS assessed by Investigator and IRC per RECIST v1.1 • OS • PFS and OS rates at 6, 9, and 12 months, assessed by Investigator and IRC • TTR and TTP assessed by Investigator and IRC per RECIST v1.1, Plasma concentration summary and separate population PK analysis of lirafugratinib, ER for efficacy and safety if the PK, efficacy, and safety of lirafugratinib are substantially different from the previous observations, • QoL assessed by EORTC QLQ-C30 • TTD, defined as time from the first dose of lirafugratinib to first deterioration (a score decrease of ≥10 from baseline) maintained for 2 consecutive timepoints, or one timepoint followed by death (from any cause) within 4 weeks

Source: https://euclinicaltrials.eu/ctis-public/view/2025-523923-22-00